EU clinical trial 2022-502099-22-01: A Phase 3, Randomized, Active-Controlled, Double-Blind Clinical Study to Evaluate the Antiretroviral Activity, Safety, and Tolerability of Doravirine/Islatravir (DOR/ISL 100 mg/0.25 mg) Once-Daily in HIV-1 Infected Treatment-Naïve Participants
Protocol code: MK-8591A-053
Sponsor: Merck Sharp & Dohme LLC (Pharmaceutical company). Phase: Therapeutic confirmatory (Phase III). Countries: Germany (ongoing, recruitment ended), France (ongoing, recruitment ended), Spain (ongoing, recruitment ended).
Therapeutic area(s): Diseases [C] - Virus Diseases [C02]
Gender: Female, Male. Age: 18-64 years, 65+ years. Enrolment: 82.
Status: Ongoing, recruitment ended. Start date (EU): 2024-04-29. Decision date: 2024-03-25. Results received: No. Last updated: 2026-07-10.
Decision dates by country: DE: 2024-03-26, FR: 2024-03-25, ES: 2024-04-01

Condition(s): HIV-1 Infection
Product: MK-8591A, Placebo to doravirine/ islatravir, Biktarvy 50 mg/200 mg/25 mg film-coated tablets, Biktarvy 50 mg/200 mg/25 mg film-coated tablets, Placebo to bictegravir/ emtricitabine/ tenofovir alafenamide

Primary endpoint: Percentage of participants with human immunodeficiency virus type 1 (HIV-1) ribonucleic acid (RNA) ≥50 copies/mL at Week 48, Percentage of participants experiencing ≥1 adverse event (AE) through Week 48, Percentage of participants discontinuing from study treatment due to an AE through Week 48
Endpoint(s): Percentage of participants with HIV-1 RNA <50 copies/mL at Week 96, Percentage of participants with HIV-1 RNA <200 copies/mL at Week 48, Percentage of participants with HIV-1 RNA <200 copies/mL at Week 96, Change from baseline in cluster of differentiation 4+ (CD4+) T-cells at Week 48, Change from baseline in CD4+ T-cells at Week 96, Incidence of viral drug resistance, Change from baseline in body weight at Week 48, Change from baseline in body weight at Week 96, Percentage of participants experiencing ≥1 AE through Week 96, Percentage of participants discontinuing from study treatment due to an AE through Week 48, Percentage of participants with HIV-1 RNA <50 copies/mL at Week 144, Percentage of participants with HIV-1 RNA <200 copies/mL at Week 144., Change from baseline in CD4+ T-cells at Week 144., Change from baseline in body weight at Week 144

Source: https://euclinicaltrials.eu/ctis-public/view/2022-502099-22-01